EU clinical trial 2023-509021-53-00: A follow-up project on the GADinLADA trial to test for the continued impact of HLA-DR3DQ2 on diabetes status and immune parameters 3 years after treatment with intranodal GAD-alum.
Sponsor: Norwegian University Of Science And Technolology (Educational Institution). Phase: Therapeutic exploratory (Phase II). Countries: Norway (ongoing, recruitment ended), Sweden (ongoing, recruitment ended).
Therapeutic area(s): Diseases [C] - Immune System Diseases [C20]
Gender: Female, Male. Age: 18-64 years, 65+ years. Enrolment: 14.
Status: Ongoing, recruitment ended. Start date (EU): 2024-06-05. Decision date: 2024-05-03. Results received: No. Last updated: 2025-07-21.
Decision dates by country: NO: 2024-06-03, SE: 2024-05-27

Condition(s): Latent Autoimmune Diabetes in Adults (LADA)
Product: Diamyd

Primary endpoint: Change in diabetes status variables (beta cell insulin secretion capacity and metabolic control) 3 years after treatment with GAD-alum (IMP) in the GADinLADA study, compared to baseline and the end of study (i.e., 12 months after baseline) in GADinLADA.

Source: https://euclinicaltrials.eu/ctis-public/view/2023-509021-53-00